EU clinical trial 2024-519050-37-00: ORGAN SPARING FOR LOCALLY ADVANCED RECTAL CANCER AFTER NEOADJUVANT TREATMENT FOLLOWED BY ELECTROCHEMOTHERAPY - LARC_ DEEP_CANCERS
Sponsor: IRCCS Istituto Nazionale Tumori Fondazione Pascale (Hospital/Clinic/Other health care facility). Phase: Therapeutic exploratory (Phase II). Countries: Italy (authorised, recruitment pending).
Therapeutic area(s): Diseases [C] - Neoplasms [C04]
Gender: Female, Male. Age: 18-64 years, 65+ years. Enrolment: 70.
Status: Authorised, recruitment pending. Decision date: 2025-01-10. Results received: No. Last updated: 2025-01-10.

Condition(s): colorectal cancer
Product: BLEOMYCIN

Primary endpoint: Evaluation of the safety and feasibility, Increase in the rate of complete histopathological response in the treatment arm compared to the control arm.

Source: https://euclinicaltrials.eu/ctis-public/view/2024-519050-37-00